EU clinical trial 2025-522460-33-00: An Open-Label, Single-Arm, 3-Year Extension Study to Evaluate Safety and Tolerability of Tinlarebant in Subjects with Stargardt Disease
Protocol code: LBS-008-CT08
Sponsor: Belite Bio Inc. (Pharmaceutical company). Phase: Therapeutic confirmatory (Phase III). Countries: Netherlands (authorised, recruitment pending), France (authorised, recruiting), Belgium (authorised, recruitment pending).
Therapeutic area(s): Diseases [C] - Eye Diseases [C11]
Gender: Female, Male. Age: 0-17 years, 18-64 years. Enrolment: 6.
Start date (EU): 2026-06-26. Decision date: 2026-04-07. Results received: No. Last updated: 2026-04-08.
Decision dates by country: BE: 2026-04-08, FR: 2026-04-08, NL: 2026-04-07

Condition(s): Stargardt Disease
Product: LBS-008

Primary endpoint: Change in DDAF (Definitely decreased autofluorescence) assessed by FAF (Fundus autofluorescence) photography, Change in QDAF (Questionably decreased autofluorescence) assessed by FAF (Fundus autofluorescence) photography, Change in DAF (Decreased autofluorescence) assessed by FAF (Fundus autofluorescence) photography

Source: https://euclinicaltrials.eu/ctis-public/view/2025-522460-33-00